EU clinical trial 2023-508586-33-00: HOVON 174 MM: FeAsiBility of a treatment free interval in newly diagnosed mUltiple myeLOma patients treated with DaratumUmab-Lenalidomide-DexamethaSone – the FABULOUS study
Sponsor: Stichting Hemato-Oncologie voor Volwassenen Nederland (Hovon) (Hospital/Clinic/Other health care facility). Phase: Therapeutic confirmatory (Phase III). Countries: Netherlands (ongoing, recruiting).
Therapeutic area(s): Diseases [C] - Neoplasms [C04]
Gender: Female, Male. Age: 18-64 years, 65+ years. Enrolment: 599.
Status: Ongoing, recruiting. Start date (EU): 2024-05-14. Decision date: 2024-03-11. Results received: No. Last updated: 2026-06-25.

Condition(s): multiple myeloma
Product: DARATUMUMAB, LENALIDOMIDE, DEXAMETHASONE

Primary endpoint: Event free survival (EFS) from the time of randomization, with events being defined as: PD, death, going off protocol treatment due to toxicity, biochemical progression within 4 months after discontinuation of therapy in arm B or less than minimal response after 4 cycles of therapy after the restart of Dara-Rd in arm B, whichever comes first (see protocol section 10.4 for definitions of PD and biochemical progression), Progression free survival (PFS) from the time of randomization, with events being defined as PD (according to definition in section 10.4) or death, whichever comes first
Endpoint(s): Toxicity, according to CTCAE v5, Adverse event (AE) burden, Quality of Life and PROMs, Cost-effectiveness analysis, Treatment-free interval (TFI) in arm B, Time to response and to maximal response after restart of Dara-Rd in arm B, Time to next treatment (TTNT), PFS2 from the time of randomization to 2nd PD or death, whichever comes first, OS from time of randomization to death from any cause; patients still alive at the date of last contact will be censored, Discontinuation rate and the reasons for discontinuation, Cumulative dose and relative dose intensity (RDI) of daratumumab, lenalidomide and dexamethasone, Dose reductions of daratumumab, lenalidomide and dexamethasone

Source: https://euclinicaltrials.eu/ctis-public/view/2023-508586-33-00